EU clinical trial 2024-515579-36-00: Hydroxychloroquine treatment for Recurrent Pregnancy Loss: a randomized double-blind placebo-controlled trial
Sponsor: Hvidovre Hospital (Hospital/Clinic/Other health care facility). Phase: Therapeutic exploratory (Phase II). Countries: Denmark (ongoing, recruiting).
Therapeutic area(s): Diseases [C] - Female Urogenital Diseases and Pregnancy Complications [C13]
Gender: Female. Age: 18-64 years. Enrolment: 186.
Status: Ongoing, recruiting. Start date (EU): 2017-04-12. Decision date: 2024-07-25. Results received: No. Last updated: 2025-12-02.

Condition(s): Recurrent Pregnancy Loss
Product: Plaquenil, filmovertrukne tabletter, Lactose monohydrate

Primary endpoint: The trial will conclude after the inclusion and follow-up (pregnancy loss or 6 months after live birth) for 186 women. Included women who become pregnant less than two months after starting the medication or do not achieve pregnancy within one year of starting the medication will be replaced 1:1 by new patients included in the trial.

Source: https://euclinicaltrials.eu/ctis-public/view/2024-515579-36-00